EU clinical trial 2023-507994-16-00: A Long-term Follow-up Study to Evaluate the Safety and Efficacy of Retinal Gene Therapy in Subjects with Choroideremia Previously Treated with Adeno-Associated Viral Vector Encoding Rab Escort Protein-1 (AAV2-REP1) and in Subjects with X-Linked Retinitis Pigmentosa Previously Treated with Adeno-Associated Viral Vector Encoding RPGR (AAV8-RPGR) in an Antecedent Study (SOLSTICE)
Protocol code: NSR-CHM-OS2 273CH201
Sponsor: Biogen Idec Research Limited (Pharmaceutical company). Phase: Therapeutic confirmatory (Phase III). Countries: France (ended), Germany (ended).
Therapeutic area(s): Diseases [C] - Eye Diseases [C11]
Gender: Male. Age: 18-64 years. Enrolment: 54.
Status: Ended. Start date (EU): 2024-10-07. End date (EU): 2026-06-23. Decision date: 2024-10-01. Results received: No. Last updated: 2025-12-12.
Decision dates by country: FR: 2024-10-01, DE: 2024-10-07

Condition(s): Choroideremia (CHM) X-Linked Retinitis Pigmentosa (XLRP)
Product: BIIB111

Primary endpoint: Safety assessments will be performed as per protocol
Endpoint(s): Change from Baseline in best-corrected visual acuity (BCVA) as measured by the Early Treatment of Diabetic Retinopathy Study (ETDRS) chart, Proportion of participants with no decrease from Baseline in BCVA or a decrease from Baseline in BCVA of <5 ETDRS letters (in CHM subjects only), Proportion of participants with an increase from Baseline in BCVA of ≥ 10 ETDRS letters (in CHM subjects only), Proportion of participants with an increase from Baseline in BCVA of ≥ 15 ETDRS letters (in CHM subjects only), Available assessments of fundus autofluorescence at each visit, Available assessments of fundus photography at each visit, Available assessments of spectral-domain optical coherence tomography (SD-OCT) at each visit, Available assessments of microperimetry at each visit, Change from Baseline in the 25-Item Visual Function Questionnaire (VFQ-25), Change from Baseline in visual field (in AAV8-RPGR-treated participants only), Proportion of participants with an increase from Baseline in low luminance visual acuity (LLVA) of ≥10 ETDRS letters (in AAV8-RPGRtreated participants only), Proportion of participants with an increase from Baseline in LLVA of ≥ 15 ETDRS letters (in AAV8-RPGR-treated participants only), Datasets from the 2 disease populations will be analyzed separately.

Source: https://euclinicaltrials.eu/ctis-public/view/2023-507994-16-00